EU clinical trial 2024-512459-19-00: Prospective, multicentre, open-label clinical trial on the effect of GUSelkumab on the resolution of ultrasound-proven ENThEsitis in patients with pSoriatic arthriTis
Sponsor: Universitaetsklinikum Erlangen AöR (Hospital/Clinic/Other health care facility). Phase: Therapeutic use (Phase IV). Countries: Germany (ongoing, recruiting).
Therapeutic area(s): Diseases [C] - Immune System Diseases [C20]
Gender: Female, Male. Age: 18-64 years, 65+ years. Enrolment: 78.
Status: Ongoing, recruiting. Start date (EU): 2024-09-13. Decision date: 2024-06-11. Results received: No. Last updated: 2026-06-03.

Condition(s): Psoriatic arthritis
Product: Tremfya 100 mg solution for injection in pre-filled pen., Tremfya 100 mg solution for injection in pre-filled syringe

Primary endpoint: Resolution of enthesitis (SPARCC = 0) at week 24

Source: https://euclinicaltrials.eu/ctis-public/view/2024-512459-19-00